EU clinical trial 2024-513078-23-00: CHACRY-1501 : RISK OF INFERTILITY RELATED TO ADJUVANT CHEMOTHERAPY IN YOUNG BREAST CANCER PATIENTS: OOCYTE/EMBRYO CRYOPRESERVATION
Protocol code: CHACRY-1501
Sponsor: Centre Oscar Lambret (Pharmaceutical company). Phase: Therapeutic exploratory (Phase II). Countries: France (ongoing, recruitment ended).
Therapeutic area(s): Diseases [C] - Neoplasms [C04]
Gender: Female. Age: 18-64 years. Enrolment: 139.
Status: Ongoing, recruitment ended. Start date (EU): 2016-12-02. Decision date: 2024-06-26. Results received: No. Last updated: 2025-01-31.

Condition(s): breast cancer in young women
Product: FOLLITROPIN BETA, FOLLITROPIN ALFA

Primary endpoint: Quality of the oocyte retrieval will be evaluated in terms of numbers of Meta II oocytes that can be vitrified
Endpoint(s): Quality of oocyte and embryo retrieval will also be evaluated in terms of: • Total number of embryos and oocytes preserved • Rate of top quality embryos • Number of mature, immature and atretic oocytes, The ovarian reserve at study entry will be described in terms of AMH level and Antral Follicle Count (AFC). A patient will be classified as eligible for the controlled ovarian stimulation (second part of the study) if the ovarian reserve is sufficient, defined as AMH≥ 6 pmol/l or AFC ≥ 6 follicles., Safety of the study procedures shall be evaluated over the month following the egg retrieval and judged on the NCI-CTCAE scale, version 4.0, and in terms of suggestive clinical, ultrasound and/or biological signs requiring at least an additional visit to the reproductive medicine center.Hyperstimulation syndrome (OHSS) will be graded according to Delvigne criteria. after the end of standard chemotherapy adverse events related to the study procedures will be reported., The impact of the fertility preservation program on the schedule of anti-cancer treatment will be evaluated in terms of the time interval between surgery and the start of chemotherapy. A delayed start of chemotherapy is defined as a time interval greater than 60 days from the date of surgery. If chemotherapy is started more than 74 days after surgery, this will be considered as protocol deviation., Gonadotoxicity of chemotherapy will be evaluated AMH level and AFC, and in terms of chemotherapy-induced amenorrhea defined as a time interval from last periods greater than 90 days. Premature ovarian failure and chemotherapy-induced definitive menopause are defined as a time interval from last periods greater than 1 year and 2 years, respectively., All pregnancies will be reported with the type of pregnancy (spontaneous versus assisted pregnancy without or with frozen gametes) and the pregnancy outcome (miscarriage or live birth, single or multiple) over a 10–year period after the end of chemotherapy or until 43 years old, Disease-free survival is defined as the time interval from the date of surgery until the date of the first relapse (locoregional or metastasic recurrence) or death from any cause. Data will be censored at last follow-up visit for patients alive free of disease, OPTIONAL TRANSLATIONAL RESEARCH (ONLY IN LILLE AND MONTPELLIER) Circulating nucleic acids quantification: - Circulating miRNAs will be extracted from serum samples and then they will be quantified by quantitative real-time RT-PCR. - Quantification of cell-free DNA in serum samples will be performed by quantitative real-time PCR.

Source: https://euclinicaltrials.eu/ctis-public/view/2024-513078-23-00